EU clinical trial 2023-504071-24-00: LiBRA – Lithium treatment to prevent cognitive impairment after brain radiotherapy.
Protocol code: LiBRA
Sponsor: Karolinska University Hospital (Hospital/Clinic/Other health care facility). Phase: Therapeutic exploratory (Phase II). Countries: Sweden (ongoing, recruiting), Denmark (ongoing, recruiting).
Therapeutic area(s): Diseases [C] - Neoplasms [C04]
Gender: Female, Male. Age: 0-17 years, 18-64 years. Enrolment: 114.
Status: Ongoing, recruiting. Start date (EU): 2023-11-07. Decision date: 2023-05-02. Results received: No. Last updated: 2026-05-20.
Decision dates by country: DK: 2024-05-22, SE: 2023-05-02

Condition(s): Brain tumor
Product: PLACEBO MATCHING 42MG LITHIONIT, 10MM, WHITE, ROUND TABLETS, Lithionit 42 mg (6 mmol) depottablett

Primary endpoint: Change in Processing Speed Index (PSI) test score (sub-test of WPPSI/WISC/WAIS) 2 years after the start of study treatment compared to baseline, before study treatment.
Endpoint(s): Changes in the following neuropsychological/other test scores: • Complete set of WPPSI-IV/WISC-V/WAIS-IV sub-tests and their associated indices: o Processing Speed Index (PSI) o Verbal Comprehension Index (VCI) o Visual Spatial Index (VSI) o Fluid Reasoning Index (FRI) o Working Memory Index (WMI), Changes in Grooved Pegboard (motor speed), Changes in Beery/Buktenica VMI (visual-motor integration), Changes in Conner´s CPT III (sustained attention), Changes in D-KEFS TMT, D-KEFS CWT, D-KEFS Verbal fluency (executive functions) o If age <8 years: Nepsy II: Inhibition, Verbal fluency, Changes in Nepsy Word list (memory), Changes in Pediatric Quality of Life (PedsQL) Generic Core Scale Standard, Multidimensional Fatigue Scale., Changes in UCLA Loneliness Rating Scale 3 (ULS-3), Changes in Strengths and Difficulties Questionnaire (SDQ), Changes in Behavior Rating Inventory of Executive Function (BRIEF), Changes in the following neuropsychological/other test scores: o Processing Speed Index (PSI) o Working Memory Index (WMI), Evaluation of volumetric measures (hippocampal, total gray matter and total white matter volume) and diffusion tensor imaging (DTI) indices (FA, MD, RD, AD) on brain MRI at 6 months, 1 year, 2 years, 5 years and 10 years after start of study treatment, compared to baseline.

Source: https://euclinicaltrials.eu/ctis-public/view/2023-504071-24-00